EU clinical trial 2024-511861-12-00: Local and systemic safety and tolerability of ascending doses of TOP-N53, a nitric oxide (NO)-releasing phosphodiesterase-5 (PDE5) inhibitor, administered topically, on wound in patients with digital ulcers (DU) in systemic sclerosis (SSc) in an open-label, vehicle-controlled, phase 2a, multi-center clinical trial
Protocol code: TOP-N53-02
Sponsor: Topadur Pharma Deutschland GmbH, Topadur Pharma AG (Pharmaceutical company). Phase: Phase I and Phase II (Integrated)- First administration to humans. Countries: France (ongoing, recruiting).
Therapeutic area(s): Diseases [C] - Skin and Connective Tissue Diseases [C17]
Gender: Female, Male. Age: 18-64 years, 65+ years. Enrolment: 8.
Status: Ongoing, recruiting. Start date (EU): 2025-02-04. Decision date: 2024-12-02. Results received: No. Last updated: 2026-07-10.

Condition(s): Digital ulcers in systemic sclerosis
Product: Sildenafil Teva 20 mg filmomhulde tabletten, TOP-N53, Vehicle to TOP-N53

Primary endpoint: Local treatment emergent adverse events (TEAEs): Frequency of local TEAEs from treatment initiation until follow-up (FU) visit, Investigator-solicited DU-related patient reported outcomes (DU-PROs)- Pain: Per dose/time escalation step at the respective assessment time points: - Frequency and mean score of pain (actual) at the cardinal DU as assessed by using a numeric rating scale (NRS, graduating intensity from 0 [‘no pain’] to 10 [‘worst imaginable pain’])
Endpoint(s): Daily diary DU-PROs: Per dose/time escalation step: - Frequency and mean score of pain (worst intensity during last 24 h) at the cardinal DU as assessed by using NRS (graduating intensity from 0 [‘no pain’] to 10 [‘worst imaginable pain’]), Daily diary DU-PROs Per dose/time escalation step: - Frequency and mean score of itching (worst intensity during last 24 h) at the cardinal DU as assessed by using NRS (graduating intensity from 0 [‘no pain’] to 10 [‘worst imaginable pain’]), Daily diary DU-PROs: Per dose/time escalation step: - Frequency and mean score of RP by scoring using the RCS, an 0-10 ordinal scale from ‘no difficulty’ (0) to ‘extreme difficulty’, number of RP attacks and occurrence of tingling and numbness, Daily diary DU-PROs: Per dose/time escalation step: - Frequency of systemic TEAEs from treatment initiation until FU visit, Daily diary DU-PROs: Per dose/time escalation step at the respective assessment time points: - Vital signs: Mean systemic arterial BP and mean pulse rate, aural body temperature (only at screening, prior IP exposure when participant arrives, and at the FU visit), frequency of clinically significant abnormal values, Daily diary DU-PROs: Per cohort at screening (Days -10 to -3) and FU visit (7 + 2 days after last treatment): - 12 lead electrocardiogram (ECG): mean and mean changes in ECG values, frequency of clinically significant abnormal values, Daily diary DU-PROs: Per cohort at screening (Days -10 to -3) and FU visit (7 + 2 days after last treatment): - Safety laboratory (clinical chemistry, hematology, urinalysis, serology): mean and mean changes in laboratory values, frequency of clinically significant abnormal values, Clinical DU assessment (CDUA) endpoints: Per dose/time escalation step as assessed by the investigator live at the respective assessment time points: - Frequency and mean score of erythema at the peri ulcer area of the cardinal DU (by scoring using a 7-point Robinson scale), Clinical DU assessment (CDUA) endpoints: Per dose/time escalation step as assessed by the investigator live at the respective assessment time points: - Frequency of bruising at the peri-ulcer area of the cardinal DU or beyond (as assessed by closed question: YES/NO), Clinical DU assessment (CDUA) endpoints Per dose/time escalation step as assessed by the investigator live at the respective assessment time points: - Frequency of hemorrhage in the cardinal DU (as assessed by closed question: YES/NO), Clinical DU assessment (CDUA) endpoints: Per dose/time escalation step as assessed by the investigator live at the respective assessment time points: - Frequency of perilesional newly emerging, wound related edema at the cardinal DU (as assessed by closed question: YES/NO), Clinical DU assessment (CDUA) endpoints: Per dose/time escalation step as assessed by the investigator live at the respective assessment time points: - Frequency of clinical infection at the cardinal DU (as assessed by closed question: YES/NO), Investigator-solicited DU-related patient reported outcomes (DU-PROs) - Itching: Per dose/time escalation step at the respective assessment time points: - Frequency and mean score of itching (actual) at the cardinal DU as assessed by using NRS (graduating intensity from 0 [‘no itch’] to 10 [‘worst imaginable itch’]), Further investigator-solicited DU-PRO: Per dose/time escalation step at the respective assessment time points: - Number of RP attacks since IP 1/2 initiation (0–5 min time point), Further investigator-solicited DU-PRO: Per dose/time escalation step at the respective assessment time points: - Number of RP attacks since IP 1/2 removal (60 min time point), Further assessments: Per dose/time escalation step at the respective assessment time points: - Wound tissue type assessment (estimated percentage of granulating, epithelializing, necrotic, sloughy [fibrinous] tissue categorized in steps of 10% intervals) as assessed by clinical evaluation (investigator), Further assessments: Per dose/time escalation step at the respective assessment time points: - Mean delta finger to palm (dFTP) [cm] reflecting hand function (finger motion) measured on the hand with the cardinal DU

Source: https://euclinicaltrials.eu/ctis-public/view/2024-511861-12-00